EU clinical trial 2024-516725-31-00: VICTORIA (hormone receptor postiVe endometrIal Carcinoma treated by dual mTORC1/mTORC2 Inhibitor and Anastrozole):A Multicentric, randomized, non comparative, open-label Phase I/II evaluating AZD2014 (dual mTORC1/mTORC2 inhibitor) in combination with anastrozole versus anastrozole alone in the treatment of metastatic hormone receptor-positive endometrial adenocarcinoma
Protocol code: ET-15-036
Sponsor: Centre Leon Berard (Hospital/Clinic/Other health care facility). Phase: Phase I and Phase II (Integrated)- Other. Countries: France (ongoing, recruiting).
Therapeutic area(s): Diseases [C] - Neoplasms [C04]
Gender: Female. Age: 18-64 years, 65+ years. Enrolment: 72.
Status: Ongoing, recruiting. Start date (EU): 2016-04-14. Decision date: 2024-11-27. Results received: No. Last updated: 2024-11-27.

Condition(s): advanced and metastatic

Source: https://euclinicaltrials.eu/ctis-public/view/2024-516725-31-00